EU clinical trial 2024-516147-32-00: A PHASE 1/2, DOSE AND SCHEDULE EVALUATION STUDY TO INVESTIGATE THE SAFETY AND CLINICAL ACTIVITY OF BELANTAMAB MAFODOTIN ADMINISTERED IN COMBINATION WITH POMALIDOMIDE AND DEXAMETHASONE WITH OR WITHOUT DARATUMUMAB IN PATIENTS WITH RELAPSED/REFRACTORY MULTIPLE MYELOMA PREVIOUSLY TREATED WITH ONE TO THREE LINES OF THERAPY WHO ARE LENALIDOMIDE REFRACTORY
Protocol code: EAE127
Sponsor: Hellenic Society Of Hematology (Patient organisation/association). Phase: Phase I and Phase II (Integrated)- Other. Countries: Greece (ongoing, recruitment ended).
Therapeutic area(s): Diseases [C] - Neoplasms [C04]
Gender: Female, Male. Age: 18-64 years, 65+ years. Enrolment: 12.
Status: Ongoing, recruitment ended. Start date (EU): 2022-12-06. Decision date: 2024-11-27. Results received: No. Last updated: 2026-02-26.

Condition(s): Relapsed/refractory multiple myeloma
Product: POMALIDOMIDE, POMALIDOMIDE, POMALIDOMIDE, POMALIDOMIDE, DARZALEX 1800 mg solution for injection, DEXAMETHASONE, DEXAMETHASONE

Primary endpoint: • Number of participants with dose-limiting toxicities (DLTs). • Number of participants with AEs and serious adverse events (SAEs). • Number of participants with ocular toxicity of Grade ≥2 (per KVA scale). Part 2 • Overall Response Rate (ORR) as per IMWG by Investigator Assessment. • Number of participants with AEs and SAEs. • Number of participants with ocular toxicity of Grade ≥2 (per KVA scale).
Endpoint(s): • Cumulative administered dose of belantamab mafodotin in combination with daratumumab, pomalidomide, and dexamethasone or in combination with pomalidomide and dexamethasone., • ORR as per IMWG 2016, • Very Good Partial Response (VGPR) or better (VGPR+) rate., • Time to Response (TTR) as per IMWG 2016 by Investigator assessment., • Duration of Response (DoR) as per IMWG 2016 by Investigator assessment., • Complete Response Rate (CRR) as per IMWG 2016 by Investigator assessment., • Minimal residual disease (MRD) negativity rate in the BM, Negative MRD is defined as the absence of tumor plasma cells in minimum 100,000 (105) BM cells. MRD will be assessed via next-generation flow (NGF) cytometry in participants with VGPR or better response., • Progression-Free Survival (PFS) as per IMWG 2016 by Investigator assessment., • Overall Survival (OS)., • Number of participants with abnormal ocular findings (on ophthalmic exam)., • Belantamab mafodotin dose holds., • Belantamab mafodotin observed plasma concentrations., • Number and proportion of participants with changes from baseline in ocular symptoms and related impacts as measured by the Vision Related Anamnestic Tool.

Source: https://euclinicaltrials.eu/ctis-public/view/2024-516147-32-00